EU clinical trial 2024-517232-22-00: A Phase 3, Randomized, Open-label, Multicenter Clinical Study to Evaluate the Safety and Efficacy of MK-1084, Cetuximab, and mFOLFOX6 versus mFOLFOX6 With or Without Bevacizumab as First-line Treatment of Participants With KRAS G12C-mutant, Locally Advanced Unresectable or Metastatic Colorectal Cancer (KANDLELIT-012).
Protocol code: MK-1084-012
Sponsor: Merck Sharp & Dohme LLC (Pharmaceutical company). Phase: Therapeutic confirmatory (Phase III). Countries: Poland (ongoing, recruiting), Spain (ongoing, recruiting), Netherlands (ongoing, recruiting), Italy (ongoing, recruiting), Finland (authorised, recruiting), Romania (ongoing, recruiting), France (ongoing, recruiting), Germany (ongoing, recruiting), Hungary (ongoing, recruiting).
Therapeutic area(s): Diseases [C] - Neoplasms [C04]
Gender: Female, Male. Age: 18-64 years, 65+ years. Enrolment: 141.
Start date (EU): 2025-09-26. Decision date: 2025-09-17. Results received: No. Last updated: 2026-05-05.
Decision dates by country: FR: 2025-09-22, FI: 2025-09-30, IT: 2025-09-22, HU: 2025-09-22, DE: 2025-09-17, PL: 2025-09-19, RO: 2025-09-22, NL: 2025-09-22, ES: 2025-09-22

Condition(s): KRAS G12C-mutant, Locally Advanced Unresectable or Metastatic Colorectal Cancer
Product: Avastin 25 mg/ml concentrate for solution for infusion., MK-1084, CALCIUM LEVOFOLINATE, MK-1084, CETUXIMAB, MVASI 25 mg/mL concentrate for solution for infusion, FLUOROURACIL, Avastin 25 mg/ml concentrate for solution for infusion., MK-1084, CALCIUM FOLINATE, OXALIPLATIN, MK-1084, MVASI 25 mg/mL concentrate for solution for infusion

Primary endpoint: Number of Participants Experiencing Dose-Limiting Toxicity (DLT), Part 1: Number of Participants Who Experience an Adverse Event (AE), Part 1: Number of Participants Who Discontinue Study Treatment Due to an AE, Progression-free Survival (PFS)
Endpoint(s): Objective Response Rate (ORR), Overall Survival (OS), Duration of Response (DOR), Part 2: Number of Participants Who Experience an AE, Part 2: Number of Participants Who Discontinue Study Treatment Due to an AE, Change from Baseline in the European Organization for Research and Treatment of Cancer (EORTC)-Quality of Life Questionnaire-Core 30 (QLQ-C30) Global Health Status (Item 29) and Quality of Life (Item 30) Combined Score, Change from Baseline in the EORTC-QLQ-C30 Physical Functioning (Items 1-5) Score, Change from Baseline in the EORTC-QLQ-C30 Role Functioning (Items 6 and 7) Score, Change from Baseline in the EORTC-QLQ-C30 Appetite Loss (Item 13) Score, Change from Baseline in the EORTC-Quality of Life Questionnaire-Colorectal Cancer-Specific 29 Items (QLQ-CR29) Bloating (Item 37) Score, Time to First Deterioration (TTD) in EORTC QLQ-C30 Global Health Status (Item 29) and Quality of Life (Item 30) Combined Score, TTD in EORTC QLQ-C30 Physical Functioning (Items 1-5) Score, TTD in EORTC QLQ-C30 Role Functioning (Items 6 and 7) Score, TTD in EORTC QLQ-C30 Appetite Loss (Item 13) Score, TTD in EORTC QLQ-CR29 Bloating (Item 37) Score

Source: https://euclinicaltrials.eu/ctis-public/view/2024-517232-22-00